EU clinical trial 2024-512596-12-00: Randomised, bioequivalence clinical trial of atorvastatin 80 mg capsules vs atorvastatin 80 mg film-coated tablets, after a single oral dose administration to healthy volunteers under fasting conditions in crossover replicated design.
Protocol code: UECHUP-ATO/24-3
Sponsor: Laboratorios Alter S.A. (Pharmaceutical company). Phase: Human Pharmacology (Phase I)- Bioequivalence Study. Countries: Spain (ended).
Therapeutic area(s): Diseases [C] - Cardiovascular Diseases [C14]
Gender: Female, Male. Age: 18-64 years. Enrolment: 48.
Status: Ended. Start date (EU): 2024-08-16. End date (EU): 2024-10-15. Decision date: 2024-06-24. Results received: No. Last updated: 2024-06-24.

Condition(s): Hypercholesterolaemia, Prevention of cardiovascular disease

Source: https://euclinicaltrials.eu/ctis-public/view/2024-512596-12-00